EU clinical trial 2024-512684-31-00: Breaking the big Five Barriers of Brain Metastasis: A prospective phase II, open-label, multi-center trial of combined nivolumab, ipilimumab and bevacizumab together with 2 cycles of induction chemotherapy in patients with non-squamous non-small-cell lung cancer (NSCLC) metastatic to the brain CA209-7WF / Break B5-BM-NSCLC
Protocol code: CA209-7WF/ Break B5
Sponsor: Universitaetsklinikum Regensburg AöR (Hospital/Clinic/Other health care facility). Phase: Therapeutic exploratory (Phase II). Countries: Germany (ended).
Therapeutic area(s): Diseases [C] - Respiratory Tract Diseases [C08]; Diseases [C] - Neoplasms [C04]
Gender: Female, Male. Age: 18-64 years, 65+ years. Enrolment: 39.
Status: Ended. Start date (EU): 2021-04-14. End date (EU): 2026-07-27. Decision date: 2024-08-26. Results received: No. Last updated: 2026-02-27.

Condition(s): non-squamous nonsmall-cell lung cancer (NSCLC) metastatic to the brain
Product: PACLITAXEL, YERVOY 5 mg/ml concentrate for solution for infusion, CARBOPLATIN, Zirabev 25 mg/ml concentrate for solution for infusion., OPDIVO 10 mg/mL concentrate for solution for infusion.

Primary endpoint: Primary Safety Endpoint Safety will be monitored throughout the whole study, with a specific focus on the safety-lead-in phase. • Predefined dosis limiting toxicities (DLTs) will be counted and dosing will adjusted according to the recommendations of the DSMB. • Incidence and intensity of adverse events (AEs) and serious adverse events (SAEs) according to Common Terminology Criteria for Adverse Events (CTCAE) version v5., Primary efficacy Endpoint Central nervous system (CNS) clinical benefit rate (CBR) defined as the proportion (pCBR) of all treated patients whose best CNS response is either • Intracranial complete response [CR], OR • Intracranial partial response [PR] OR • Intracranial stable disease [SD] ≥ 6 months
Endpoint(s): Intracranial progression free survival (iPFS), Extracranial progression free survival (ePFS), Bi-compartimental progression-free survival, Overall survival (OS), OS rate at 12 and 24 months, Duration of response (DOR) per RANO BM and Response Evaluation Criteria in Solid Tumors (RECIST v1.1), CNS specific safety and tolerability of the combination regimen in patients with or without stereotactic radiotherapy (SRT) received prior to study entry., Patient reported outcomes (PROs) of lung cancer symptoms, patient functioning, and health related quality of life (HRQoL), using the European Organisation for Research and Treatment of Cancer (EORTC) Quality-of- Life Questionnaire Core 30 (QLQ-C30), Quality-of-Life Questionnaire brain module (EORTC QLQ-BN20) and Lung Cancer Module (LC29), Exploratory biomarkers

Source: https://euclinicaltrials.eu/ctis-public/view/2024-512684-31-00